EU clinical trial 2022-500470-33-00: B7841007 - An Open-Label Extension Study to Evaluate the Long-Term Safety, Tolerability, and Efficacy of Marstacimab Prophylaxis in Severe (Coagulation Factor Activity <1%) Hemophilia A Participants With or Without Inhibitors or Moderately Severe to Severe Hemophilia B Participants (Coagulation Factor Activity ≤2%) With or Without Inhibitors
Protocol code: B7841007
Sponsor: Pfizer Inc. (Pharmaceutical company). Phase: Therapeutic confirmatory (Phase III). Countries: Spain (ongoing, recruiting), Croatia (ongoing, recruiting), Italy (ongoing, recruiting), France (ongoing, recruiting), Austria (authorised, recruitment pending), Czechia (authorised, recruitment pending), Denmark (ongoing, recruiting), Germany (authorised, recruitment pending), Slovakia (ongoing, recruiting).
Therapeutic area(s): Diseases [C] - Hemic and Lymphatic Diseases [C15]
Gender: Male. Age: 0-17 years, 18-64 years, 65+ years. Enrolment: 27.
Start date (EU): 2022-11-14. Decision date: 2022-09-06. Results received: No. Last updated: 2026-08-07.
Decision dates by country: ES: 2022-09-09, AT: 2025-02-10, CZ: 2025-02-06, HR: 2022-09-16, DE: 2025-01-31, FR: 2022-09-06, IT: 2022-09-13, DK: 2025-01-31, SK: 2025-01-14

Condition(s): Haemophilia
Product: Marstacimab

Primary endpoint: Safety Endpoints •AEs and SAEs, Incidence and severity of thrombotic events., Incidence and severity of thrombotic microangiopathy., Disseminated intravascular coagulation/consumption coagulopathy., Immunogenicity (incidence of ADA and clinically significantly persistent NAb against marstacimab)., Incidence and severity of injection site reaction., Changes in vital signs., Incidence of clinically significant laboratory value abnormalities., Incidence of severe hypersensitivity and anaphylactic reactions.
Endpoint(s): The following efficacy endpoints will be reported for each year of participation (Year 1, Year 2, etc): •Annualized rate of treated bleeding episodes., Incidence of joint bleeds., Incidence of spontaneous bleeds., Incidence of target joint bleeds, Incidence of total bleeds (treated and untreated)., Change in joints as measured by the HJHS for participants ≥4 years of age., Number of target joints, Haem-A-QoL (≥17 years of age)/Haemo-QoL (age-dependent versions 12 to <17 years of age and 8 to <12 years of age)., Health Utilities Measure (EQ-5D-5L) for participants ≥12 years of age., Total coagulation factor or bypass product consumption., Health Utilities Measure (EQ-5D-Y) Self Assessment for participants ≥7 to ≤11 years of age, Health Utilities Measure (EQ-5D-Y) Proxy Assessment for participants ≥4 to ≤ 6 years of age

Source: https://euclinicaltrials.eu/ctis-public/view/2022-500470-33-00